EU clinical trial 2025-523835-20-00: Phase 1-2, Open-Label, Single and Multiple Ascending Dose Study to Evaluate Safety, Tolerability, Pharmacokinetics, and Pharmacodynamics of Intrathecally-Administered ION337 in Patients with Dravet Syndrome
Protocol code: ION337-CS1
Sponsor: Ionis Pharmaceuticals Inc. (Pharmaceutical company). Phase: Phase I and Phase II (Integrated)- First administration to humans. Countries: Spain (authorised, recruitment pending), France (authorised, recruitment pending), Belgium (authorised, recruitment pending), Portugal (authorised, recruitment pending), Germany (authorised, recruitment pending).
Therapeutic area(s): Diseases [C] - Nervous System Diseases [C10]
Gender: Female, Male. Age: 0-17 years. Enrolment: 12.
Status: Authorised, recruitment pending. Decision date: 2026-06-30. Results received: No. Last updated: 2026-07-27.
Decision dates by country: BE: 2026-06-30, FR: 2026-07-01, DE: 2026-07-02, PT: 2026-07-03, ES: 2026-07-06

Condition(s): Dravet Syndrome
Product: ION337

Primary endpoint: Incidence of TEAEs and SAEs, and clinically significant changes from Baseline in safety laboratory values, vital signs, ECGs, physical/neurological exam measures, and C-SSRS summarized by study part (Part 1/SAD and Part 2/MAD).
Endpoint(s): 1. - ION337 trough (pre-dose) in CSF and plasma for all doses in Part 1/SAD and Part 2/MAD. - Post-dose Cmax, AUC, and t1/2λz from plasma in Part 1/SAD - Post-dose Cmax, AUC, and t1/2λz from plasma in Part 2/MAD – first dose only, 2. Percent change from Baseline in 28-day normalized major motor seizure (MMS) frequency in Part 1/SAD and Part 2/MAD.

Source: https://euclinicaltrials.eu/ctis-public/view/2025-523835-20-00